EU clinical trial 2024-518004-49-00: Oxytocin and attachment development: Looking beyond the expected?
Sponsor: UZ Leuven (Hospital/Clinic/Other health care facility). Phase: Phase I and Phase II (Integrated)- Other. Countries: Belgium (ongoing, recruiting).
Therapeutic area(s): Psychiatry and Psychology [F] - Behavior and Behavior Mechanisms [F01]; Psychiatry and Psychology [F] - Psychological Phenomena [F02]
Gender: Female, Male. Age: 0-17 years. Enrolment: 200.
Status: Ongoing, recruiting. Start date (EU): 2025-10-28. Decision date: 2024-12-17. Results received: No. Last updated: 2026-02-23.

Condition(s): Healthy children
Product: NaCl 0.9% nose drops, Syntocinon 40 IE/ml neusspray, oplossing

Primary endpoint: To assess whether oxytocin affects cognitive flexibility, we will analyze perseverative errors during the PRLT and compare these errors in children that received oxytocin vs. children that received the placebo. We expect that oxytocin will attenuate learning during this test. More specifically, children that receive oxytocin will make more perseverative errors than children who received the placebo., To assess the effect of oxytocin on trust behaviour, we will analyze the changes in self-reported trust (computing a difference score comparing trust after the baseline vs. after the test. We expect to find less trust behavior decrease after the test block in the 80% baseline block condition for children who receive oxytocin (Study 1). For the other children, we predict stronger decreases in trust behavior (Study 1)., To assess the effect of oxytocin on trust behaviour, we will analyze the changes in self-reported trust (computing a difference score comparing trust after the baseline vs. after the test. We expect to find less trust behavior increase after the test block in the 20% baseline block condition for children who receive oxytocin (Study 2). For the other children, we predict stronger increases in trust behavior (Study 2)., To assess whether oxytocin attenuates dopamine responses, we will test between subsequent trials whether oxytocin decreases the negative impact of prediction error on decreases in attentional preference for mother after prediction error trials. For this purpose, we will compare performance on prediction error trials versus trials without prediction error.

Source: https://euclinicaltrials.eu/ctis-public/view/2024-518004-49-00